EU clinical trial 2022-502380-37-00: A Phase 3b Study to Evaluate the Duration of Effect of Bimatoprost SR in Participants with Open-Angle Glaucoma or Ocular Hypertension
Protocol code: 1698-301-007
Sponsor: Abbvie Deutschland GmbH & Co. KG (Pharmaceutical company). Phase: Therapeutic confirmatory (Phase III). Countries: Ireland (ended), Denmark (ended), Czechia (ended), Poland (ended), Germany (ended), Italy (ended), Bulgaria (ended).
Therapeutic area(s): Diseases [C] - Eye Diseases [C11]
Gender: Female, Male. Age: 18-64 years, 65+ years. Enrolment: 167.
Status: Ended. Start date (EU): 2019-08-02. End date (EU): 2025-07-11. End date: 2025-08-08. Decision date: 2023-09-04. Results received: Yes. Last updated: 2025-05-28.
Decision dates by country: CZ: 2023-09-06, IT: 2023-10-09, DK: 2023-09-04, IE: 2023-09-05, BG: 2023-10-10, DE: 2023-10-05, PL: 2023-09-11

Condition(s): Open-Angle Glaucoma, Ocular Hypertension
Product: Bimatoprost SR

Primary endpoint: Duration of effect of Bimatoprost SR
Endpoint(s): Adverse events; visual fields; visual acuity; macroscopic bulbar conjunctival hyperemia; slit-lamp biomicroscopic assessments; dilated ophthalmoscopic assessments (including optic disc assessment); contact ultrasound pachymetry; gonioscopy; specular microscopy

Source: https://euclinicaltrials.eu/ctis-public/view/2022-502380-37-00